EU clinical trial 2024-517939-53-00: Adoptive TIL therapy in combination with chemoimmunotherapy in advanced NSCLC patients
Protocol code: TIL in NSCLC
Sponsor: Leids Universitair Medisch Centrum (LUMC) (Hospital/Clinic/Other health care facility). Phase: Human Pharmacology (Phase I)- First administration to humans. Countries: Netherlands (ongoing, recruiting).
Therapeutic area(s): Diseases [C] - Respiratory Tract Diseases [C08]
Gender: Female, Male. Age: 18-64 years, 65+ years. Enrolment: 15.
Status: Ongoing, recruiting. Start date (EU): 2024-11-15. Decision date: 2024-11-15. Results received: No. Last updated: 2025-08-10.

Condition(s): Respiratory tract diseases

Source: https://euclinicaltrials.eu/ctis-public/view/2024-517939-53-00